EU clinical trial 2022-501904-83-00: A PHASE 1/2 STUDY OF REGN5668 (MUC16 × CD28, A COSTIMULATORY BISPECIFIC ANTIBODY) ADMINISTERED IN COMBINATION WITH OTHER AGENTS IN MUC16+ MALIGNANCIES
Protocol code: R5668-ONC-1938
Sponsor: Regeneron Pharmaceuticals Inc. (Pharmaceutical company). Phase: Phase I and Phase II (Integrated)- First administration to humans. Countries: Belgium (ongoing, recruiting), France (ongoing, recruiting), Spain (authorised, recruiting).
Therapeutic area(s): Diseases [C] - Neoplasms [C04]
Gender: Female. Age: 18-64 years, 65+ years. Enrolment: 208.
Start date (EU): 2023-09-11. Decision date: 2023-06-28. Results received: No. Last updated: 2026-04-02.
Decision dates by country: ES: 2024-01-30, BE: 2023-06-28, FR: 2024-02-26

Condition(s): Ovarian Cancer, Primary Peritoneal Cancer, Fallopian Tube Cancer
Product: Ubamatamab, Cemiplimab & Fianlimab - 2, Ubamatamab, CEMIPLIMAB, REGN5668, Cemiplimab and Fianlimab - 1, Sarilumab, REGN5668

Primary endpoint: Incidence of dose limiting toxicities (DLT), Dose escalation phase, Module 1, Incidence of DLTs, Dose escalation phase, Module 2, Incidence of treatment-emergent adverse events (TEAEs), Primary: Dose escalation phase, Secondary: Dose expansion phase, Incidence of serious adverse events (SAEs), Primary: Dose escalation phase; Secondary: Dose expansion phase, Incidence of deaths, Primary: Dose escalation phase; Secondary: Dose expansion phase, Incidence of laboratory abnormalities (grade 3 or higher per National Cancer Institute Common Terminology Criteria for Adverse Events [NCI-CTCAE] version 5.0 [v5.0]), Primary: Dose escalation phase; Secondary: Dose expansion phase, Concentrations of REGN5668 in serum when dosed alone and in combination with cemiplimab or ubamatamab, Primary: Dose escalation phase, ORR defined by RECIST 1.1 (Eisenhauer, 2009) of REGN5668 in combination with cemiplimab, cemiplimab + fianlimab, or ubamatamab (separately by cohort and combination), Primary: Dose expansion phase
Endpoint(s): ORR based on RECIST 1.1, Dose escalation phase, Best Overall Response (BOR) based on RECIST 1.1, Dose escalation and expansion phases, Duration of Response (DOR) based on RECIST 1.1, Dose escalation and expansion phases, Disease Control Rate (DCR) based on RECIST 1.1, Dose escalation and expansion phases, Progression Free Survival (PFS) based on RECIST 1.1, Dose escalation and expansion phases, CA-125 change from baseline after treatment with REGN5668 in combinations with cemiplimab, cemiplimab + fianlimab, or ubamatamab (separately by cohort and combination), Dose escalation and expansion phases, Concentration of REGN5668 in serum over time when dosed alone and in combination with cemiplimab, cemiplimab + fianlimab, or ubamatamab, Dose escalation and expansion phases, Presence or absence of anti-drug antibodies against REGN5668, Dose escalation and expansion phases, Presence or absence of anti-drug antibodies against ubamatamab, Dose escalation and expansion phases, Presence or absence of anti-drug antibodies against cemiplimab, Dose escalation and expansion phases, Presence or absence of anti-drug antibodies against fianlimab, Dose escalation and expansion phases

Source: https://euclinicaltrials.eu/ctis-public/view/2022-501904-83-00